EU clinical trial 2024-518437-28-00: Lidocaine for opioid sparing in vaso-occlusive crisis of Sickle Cell Disease
Protocol code: RC24_0427
Sponsor: Centre Hospitalier Universitaire De Nantes (Hospital/Clinic/Other health care facility). Phase: Therapeutic confirmatory (Phase III). Countries: France (ongoing, recruiting).
Therapeutic area(s): Diseases [C] - Congenital, Hereditary, and Neonatal Diseases and Abnormalities [C16]
Gender: Female, Male. Age: 18-64 years, 65+ years. Enrolment: 104.
Status: Ongoing, recruiting. Start date (EU): 2026-07-03. Decision date: 2025-11-05. Results received: No. Last updated: 2025-11-05.

Condition(s): Sickle cell disease
Product: LIDOCAINE HYDROCHLORIDE, SODIUM CHLORIDE

Primary endpoint: Cumulative parenteral opioid dose between randomisation and discharge from the intensive care unit expressed in morphine milligram equivalent. Only parenteral morphine and parenteral oxycodone will be taken in account, as tramadol and codein are weak opioids, and stronger opioids like fentanyl or sufentanyl are not likely to be used for spontaneously breathing patients.
Endpoint(s): Intensive care unit length of stay, in days, from randomisation, Hospital length of stay, in days, from randomisation, Visual Analogue pain Scale score and Categorical Pain Score score during intensive care unit stay, Time from randomisation to vaso-occlusive crisis resolution, defined as presence of at least three of the following four criteria: continuous apyrexia for the last 8 hours, no need for intravenous opioid infusion for the last 8 hours, ability to walk or move without pain, and absence of spontaneous pain with a Categorical Pain Scale ≤1, Time from randomisation to the last parenteral opioid dose, Frequency of vaso-occlusive crisis complications: a) secondary acute chest syndrome (i.e. acute chest syndrome occurring after randomisation), b) need for blood transfusion, c) need for red blood cell exchange, d) need for life-supporting therapies defined as invasive mechanical ventilation or dialysis or vasopressor support, Score of French version of Adult Sickle Cell Quality of Life Measurement Information System (ASCQ-Me) at D28, Frequency of any adverse events and frequency of serious adverse events at D28, Frequency of re-admissions in hospital (medicine ward or intensive care unit) or emergency-room visits by D28, Incremental cost-effectiveness ratio (cost par Quality-Adjusted Life-Year, QALY) comparing lidocaine + standard of care to standard of care alone

Source: https://euclinicaltrials.eu/ctis-public/view/2024-518437-28-00